EU clinical trial 2024-517841-16-00: Evaluation of efficacy and tolerance of fludrocortisone (Flucortac) in the treatment of neurogenic orthostatic hypotension
Protocol code: HAC2018-001
Sponsor: H.A.C. Pharma (Pharmaceutical company). Phase: Therapeutic use (Phase IV). Countries: France (ongoing, recruiting).
Therapeutic area(s): Diseases [C] - Nervous System Diseases [C10]
Gender: Female, Male. Age: 18-64 years, 65+ years. Enrolment: 90.
Status: Ongoing, recruiting. Start date (EU): 2020-07-09. Decision date: 2024-10-29. Results received: No. Last updated: 2024-10-29.

Condition(s): Neurogenic Orthostatic Hypotension
Product: FLUCORTAC 50 microgrammes, comprimé sécable, Cellulose microcristalline 50 microgrammes

Primary endpoint: Efficacy on the systolic and diastolic BP decrease when moving from supine and stand-up position
Endpoint(s): Evaluation of the symptoms related to NOH through the OHQ scale, Evaluation of the quality of life through the SF36 scale, Collection of clinical adverse events, biological and blood pressure anomalies

Source: https://euclinicaltrials.eu/ctis-public/view/2024-517841-16-00